EU clinical trial 2022-502986-92-00: Anticoagulant Therapy in patients with atrial fibrillation after surgical Left Atrial Appendage Closure: a randomized non-inferiority trial (the ATLAAC trial)
Sponsor: Odense University Hospital (Hospital/Clinic/Other health care facility). Phase: Therapeutic use (Phase IV). Countries: Denmark (ongoing, recruiting), Sweden (ongoing, recruiting).
Therapeutic area(s): Diseases [C] - Cardiovascular Diseases [C14]
Gender: Female, Male. Age: 18-64 years, 65+ years. Enrolment: 2220.
Status: Ongoing, recruiting. Start date (EU): 2024-02-27. Decision date: 2023-06-29. Results received: No. Last updated: 2026-07-09.
Decision dates by country: SE: 2025-07-04, DK: 2023-07-24

Condition(s): Atrial fibrillation
Product: APIXABAN, RIVAROXABAN, EDOXABAN, WARFARIN SODIUM, DABIGATRAN

Primary endpoint: Stroke, peripheral embolisms and major bleeding events (composite endpoint)
Endpoint(s): Ischemic stroke, Hemorrhagic stroke, Severity of stroke according to Scandinavian Stroke Scale, Transient ischemic attack, Systemic embolism, All-cause stroke, All-cause mortality, Cardiovascular mortality, All types of bleeding leading to hospital contact, Blood transfusions, Myocardial infarction, Deep venous thrombosis, Pulmonary embolism, Length of the residual stump of the LAA, Volume of the residual stump of the LAA, Presence of contrast leakage across the closure line when relevant, Presence of thrombi in the LAA or the left atrium, Health-related quality of life scores

Source: https://euclinicaltrials.eu/ctis-public/view/2022-502986-92-00